EU clinical trial 2022-502073-42-00: AN OPEN-LABEL EXTENSION STUDY TO EVALUATE THE LONG-TERM SAFETY, TOLERABILITY, PHARMACOKINETICS, PHARMACODYNAMICS, AND ACTIVITY OF ZILUCOPLAN IN PEDIATRIC STUDY PARTICIPANTS WITH ACETYLCHOLINE RECEPTOR ANTIBODY POSITIVE GENERALIZED MYASTHENIA GRAVIS
Protocol code: MG0015
Sponsor: UCB Biopharma (Pharmaceutical company). Phase: Therapeutic confirmatory (Phase III). Countries: Poland (ongoing, recruiting), Italy (authorised, recruitment pending).
Therapeutic area(s): Diseases [C] - Nervous System Diseases [C10]
Gender: Female, Male. Age: 0-17 years. Enrolment: 4.
Start date (EU): 2025-08-18. Decision date: 2023-12-14. Results received: No. Last updated: 2026-06-05.
Decision dates by country: PL: 2023-12-14, IT: 2023-12-14

Condition(s): Generalized Myasthenia Gravis
Product: Zilbrysq 32.4 mg solution for injection in pre-filled syringe, Zilucoplan sodium, Zilbrysq 16.6 mg solution for injection in pre-filled syringe, Zilbrysq 23 mg solution for injection in pre-filled syringe

Primary endpoint: • Occurrence of treatment-emergent adverse events (TEAEs) during the course of the study • Occurrence of treatment-emergent serious adverse events (TESAEs) • Occurrence of TEAEs leading to permanent withdrawal of investigational medicinal product (IMP) • Occurrence of treatment-emergent infections
Endpoint(s): • Plasma concentration of zilucoplan (ZLP) at Week 52 • Sheep red blood cell (sRBC) lysis activity at Week 52 • Complement component 5 (C5) levels at Week 52 • Myasthenia Gravis Activities of Daily Living (MG ADL) score at Week 52 • Quantitative Myasthenia Gravis (QMG) score at Week 52

Source: https://euclinicaltrials.eu/ctis-public/view/2022-502073-42-00